EU clinical trial 2023-507319-36-00: Is antibiotic prophylaxis necessary in inguinal or femoral hernia repair for the prevention of surgical site infection in our environment?
Sponsor: Hospital Universitario De Mostoles (Hospital/Clinic/Other health care facility). Phase: Therapeutic confirmatory (Phase III). Countries: Spain (authorised, recruitment pending).
Therapeutic area(s): Analytical,Diagnostic,Therapeutic Techniques and Equipment [E]-Surgical Procedures, Operative [E04]
Gender: Female, Male. Age: 18-64 years, 65+ years. Enrolment: 518.
Status: Authorised, recruitment pending. Decision date: 2024-02-05. Results received: No. Last updated: 2024-02-05.

Condition(s): Inguinal or femoral hernia
Product: CEFAZOLINA NORMON 1 g IV POLVO Y DISOLVENTE PARA SOLUCION INYECTABLE EFG

Primary endpoint: antibiotic prophylaxis in inguinal and femoral hernia repair

Source: https://euclinicaltrials.eu/ctis-public/view/2023-507319-36-00